EU clinical trial 2025-522956-25-00: COPE-CP: The effect of Celecoxib on pain, quality of life, use of opioids, and inflammation in patients suffering from chronic pancreatitis: a multicenter randomized placebo-controlled, double-blinded clinical trial
Protocol code: 1
Sponsor: Odense University Hospital (Hospital/Clinic/Other health care facility). Phase: Therapeutic confirmatory (Phase III). Countries: Denmark (authorised, recruitment pending).
Therapeutic area(s): Diseases [C] - Digestive System Diseases [C06]
Gender: Female, Male. Age: 18-64 years, 65+ years. Enrolment: 80.
Status: Authorised, recruitment pending. Decision date: 2026-05-29. Results received: No. Last updated: 2026-05-29.

Condition(s): Chronic pancreatitis
Product: Placebo matching celecoxib 200 mg hard capsules, CELECOXIB, Pantoprazole 40 mg gastro-resistant tablets

Primary endpoint: The primary endpoint is the evaluation of the total pain burden during the 16-week treatment period. This is quantified using the validated Comprehensive Pain Assessment Tool - Short Form (COMPAT-SF). The primary analysis will be based on the Area Under the Curve (AUC) for the total pain score from baseline to week 16, comparing the Celecoxib group with the placebo group.
Endpoint(s): Weekly Pain Profile: Change in pain intensity measured weekly throughout the 16-week treatment period using the Izbicki Pain Score., Opioid Consumption: Change in total daily dose of opioids, calculated as Oral Morphine Equivalents (OME), from baseline to week 16., Systemic Inflammation: Change in plasma levels of high-sensitivity C-reactive protein (hs-CRP) from baseline to week 16., Overall Clinical Benefit: Proportion of patients reporting "adequate pain relief" (yes/no) at the end of the study., Disease Activity: Incidence of hospital admissions related to Chronic Pancreatitis (CP) and acute pancreatitis (AP) flares, defined as amylase levels > 180 U/L in venous plasma, Health-Related Quality of Life: Change in Quality of Life (QoL) measured by the validated Short Form 36 (SF-36) questionnaire, completed at the same intervals as COMPAT-SF., Safety and Tolerability: Incidence and severity of adverse events (AEs), with specific focus on peptic ulcer, gastrointestinal hemorrhage, impaired renal function, cardiovascular injury, hepatocellular injury, respiratory tract symptoms, and all-cause mortality.

Source: https://euclinicaltrials.eu/ctis-public/view/2025-522956-25-00